EU clinical trial 2024-520251-24-00: Evidence based empirical antibiotic treatment for urinary tract infections requiring hospitalisation - TRI-AB trial
Sponsor: Odense University Hospital (Hospital/Clinic/Other health care facility). Phase: Therapeutic use (Phase IV). Countries: Denmark (ongoing, recruiting).
Therapeutic area(s): Diseases [C] - Bacterial Infections and Mycoses [C01]
Gender: Female, Male. Age: 18-64 years, 65+ years. Enrolment: 618.
Status: Ongoing, recruiting. Start date (EU): 2026-05-04. Decision date: 2026-03-27. Results received: No. Last updated: 2026-03-27.

Condition(s): Complicated urinary tract infections (cUTI) requiring hospitalisation
Product: AMPICILLIN, GENTAMICIN, PIVMECILLINAM, PIPERACILLIN AND BETA-LACTAMASE INHIBITOR

Primary endpoint: Clinical cure on day 3 (resolution of cUTI-related symptoms and fever, together with clinical improvement and no need for escalating systemic antimicrobial therapy)
Endpoint(s): 30/90/365-day mortality, Microbiological cure on Day 3, Time to oral-only antibiotic therapy, Length of hospital stay, Antibiotic treatment duration (combined iv and oral), Nephrotoxicity within 30 days, Proportion of treatment-related serious adverse reactions (SAE) and suspected unexpected serious adverse reactions (SUSAR), Secondary infections (C. difficile or genital/oral Candida within 30 days of enrollment), Hospital readmission within 90 days due to UTI, Post-discharge antibiotic prescription redemption within 90 days for UTI associated antibiotics.

Source: https://euclinicaltrials.eu/ctis-public/view/2024-520251-24-00